EU clinical trial 2024-511265-11-01: Withdraw or maintain antiplatelets and anticoagulants prior to performing cold snare polypectomy of subcentimeter non-pedunculated colorectal polyps: haemorrhagic and thrombotic risks.
Protocol code: ICI22/00054
Sponsor: Fundacion Instituto De Investigacion Sanitaria Aragon (Laboratory/Research/Testing facility). Phase: Therapeutic use (Phase IV). Countries: Spain (ongoing, recruiting).
Therapeutic area(s): Diseases [C] - Digestive System Diseases [C06]
Gender: Female, Male. Age: 18-64 years, 65+ years. Enrolment: 686.
Status: Ongoing, recruiting. Start date (EU): 2024-11-19. Decision date: 2024-07-05. Results received: No. Last updated: 2026-03-02.

Condition(s): patients who are requested a colonoscopy for any indication and are under antiplatelet treatment (except ASA) or anticoagulant treatment
Product: DABIGATRAN ETEXILATE, CLOPIDOGREL, RIVAROXABAN, APIXABAN, ACENOCOUMAROL, EDOXABAN

Primary endpoint: Significant post-polypectomy hemorrhage

Source: https://euclinicaltrials.eu/ctis-public/view/2024-511265-11-01